EU clinical trial 2024-519265-22-00: Psilocybin's effects on anhedonia
Sponsor: Medical University Of Vienna (Educational Institution). Phase: Human Pharmacology (Phase I)- Other. Countries: Austria (ongoing, recruiting).
Therapeutic area(s): Psychiatry and Psychology [F] - Mental Disorders [F03]; Psychiatry and Psychology [F] - Psychological Phenomena [F02]; Psychiatry and Psychology [F] - Behavior and Behavior Mechanisms [F01]
Gender: Female, Male. Age: 18-64 years. Enrolment: 65.
Status: Ongoing, recruiting. Start date (EU): 2025-11-12. Decision date: 2025-04-14. Results received: No. Last updated: 2026-07-06.

Condition(s): Major Depressive Disorder

Source: https://euclinicaltrials.eu/ctis-public/view/2024-519265-22-00